EU clinical trial 2023-503373-37-01: Phase II, multicenter, randomized, open-label study of premenopausal women with luminal breast cancer investigating the effect of oral SERD elacestrant with/without triptorelin in the ER functional pathway and Ki67 proliferation. Preoperative trial – PremiÈRe
Protocol code: SOLTI-2104
Sponsor: Solti Group (Pharmaceutical company). Phase: Therapeutic exploratory (Phase II). Countries: Spain (ongoing, recruiting).
Therapeutic area(s): Diseases [C] - Neoplasms [C04]; Analytical, Diagnostic and Therapeutic Techniques and Equipment [E] - Therapeutics [E02]
Gender: Female. Age: 18-64 years, 65+ years. Enrolment: 96.
Status: Ongoing, recruiting. Start date (EU): 2023-09-11. Decision date: 2023-07-28. Results received: No. Last updated: 2026-06-08.

Condition(s): Premenopausal women with early luminal breast cancer
Product: TAMOXIFEN CITRATE, Elacestrant 400mg, TRIPTORELIN ACETATE

Primary endpoint: Rate of CCCA determined by central assessment by IHC Ki67 (% Ki67 ≤ 2.7%) after short-term elacestrant therapy with or without OFS.
Endpoint(s): Rate of CCCA defined as centrally assessed Ki67 ≤ 2.7% by IHC, after 4 weeks of therapy, evaluated separately in patients with Luminal A and non–Luminal A disease., Mean change in Ki67 measured by IHC Ki67 expression between pre- and post-treatment samples., Differences in differential expression (mean suppression = 100 - [geometric mean (post treatment / pre-treatment · 100)]) of proliferative genes (BIRC5, CCNB1, CDC20, CDCA1, CEP55, KNTC2, MKI67, PTTG1, RRM2, TYMS and UBE2C)., Proportion of patients switching subtype between pre- and post-treatment samples, Mean change in Ki67 expression and CCCA rate (Ki67 ≤ 2.7%) according to post-treatment estradiol (E2) levels, Mean change of E2 and FSH levels between pre- and on- treatment (D14) and posttreatment samples., Incidence and severity of adverse events, with severity, determined according to NCI CTAE v.5.0., Change from baseline in targeted clinical laboratory test results, including ECGs, Immunohistochemical (IHC) assessment of E) and PgR expression in pre-treatment and post-treatment tumor samples.

Source: https://euclinicaltrials.eu/ctis-public/view/2023-503373-37-01